EU clinical trial 2024-515542-16-03: Personalized Use of Resources Study (PURE)
Protocol code: NL73399.018.20
Sponsor: Stichting Amsterdam UMC (Hospital/Clinic/Other health care facility). Phase: Therapeutic use (Phase IV). Countries: Netherlands (ended).
Therapeutic area(s): Phenomena and Processes [G] - Reproductive and Urinary Physiological Phenomena [G08]
Gender: Female, Male. Age: 18-64 years, 65+ years. Enrolment: 25.
Status: Ended. End date (EU): 2025-01-28. Decision date: 2025-01-17. Results received: No. Last updated: 2025-01-17.

Condition(s): kidney failure werefor need for kidney transplant
Product: Advagraf 5 mg prolonged-release hard capsules, Advagraf 0.5 mg prolonged-release hard capsules, Advagraf 1 mg prolonged-release hard capsules, Envarsus 4 mg prolonged-release tablets, Envarsus 0.75 mg prolonged-release tablets, Envarsus 1 mg prolonged-release tablets

Primary endpoint: The objective is to evaluate if the LCPT dose can be reduced in comparison with tacrolimus-ER and still achieve similar tacrolimus levels in the therapeutic range in patients who have a C/D ratio < 1.05 ng/mL×1/mg.
Endpoint(s): To evaluate if the switch design of the study leads to a lower pill burden; - to evaluate if the LCPT switch leads to less side effects; - to evaluate if the LCPT switch leads to less variability in trough levels; - to evaluate if patients with CYP3A5*1 allele is a factor to consider when prescribing tacrolimus variants; and - to evaluate differences in Cmax, Tmax and 24hour AUC levels.

Source: https://euclinicaltrials.eu/ctis-public/view/2024-515542-16-03